EU clinical trial 2023-509391-42-00: A Randomized, Double-blind, Phase 3b Study to Evaluate the Short- and Long-term Efficacy and Safety of Dual Targeted Therapy With Intravenous Vedolizumab and Oral Upadacitinib Compared With Intravenous Vedolizumab and Oral Placebo for Induction Followed by Intravenous Vedolizumab Monotherapy for Maintenance in the Treatment of Adults With Moderately to Severely Active Crohn’s Disease
Protocol code: Vedolizumab-3043
Sponsor: Takeda Development Center Americas Inc. (Pharmaceutical company). Phase: Phase III and phase IV (Integrated). Countries: Netherlands (authorised, recruitment pending), Czechia (ongoing, recruiting), Germany (ongoing, recruiting), Spain (ongoing, recruiting), Denmark (ongoing, recruiting), France (ongoing, recruiting), Poland (authorised, recruitment pending), Austria (authorised, recruitment pending), Portugal (ongoing, recruiting), Norway (ongoing, recruiting), Croatia (ongoing, recruiting), Italy (ongoing, recruiting), Ireland (ongoing, recruiting), Slovenia (ongoing, recruiting), Hungary (ongoing, recruiting), Belgium (ongoing, recruiting), Greece (ongoing, recruiting), Sweden (ongoing, recruiting).
Therapeutic area(s): Diseases [C] - Digestive System Diseases [C06]
Gender: Female, Male. Age: 18-64 years, 65+ years. Enrolment: 224.
Start date (EU): 2025-06-02. Decision date: 2025-03-10. Results received: No. Last updated: 2026-08-06.
Decision dates by country: AT: 2025-04-01, HU: 2025-03-14, PT: 2025-03-10, GR: 2025-04-01, NO: 2025-04-01, CZ: 2025-03-12, SE: 2025-04-01, ES: 2025-04-01, IE: 2025-03-14, DE: 2025-03-13, DK: 2025-03-10, PL: 2025-04-01, FR: 2025-04-01, HR: 2025-04-01, SI: 2025-04-01, NL: 2025-03-12, BE: 2025-04-01, IT: 2025-03-12

Condition(s): Chron's Disease
Product: Entyvio 300 mg powder for concentrate for solution for infusion, RINVOQ 45 mg prolonged-release tablets, Placebo to Match Blinded Upadacitinib

Primary endpoint: CDAI-defined clinical remission at Week 12, defined as CDAI <150, Endoscopic response at Week 12, defined as a decrease in Simple Endoscopic Score for Crohn’s Disease (SES CD) >50% from baseline (or for participants with isolated ileal disease, SES-CD ≤4 or a ≥ 2-point reduction in SES-CD from baseline) read centrally.
Endpoint(s): PRO2-defined clinical remission at Week 12, defined as 7-day average of very soft or liquid stool frequency ≤2.8, 7-day average of abdominal pain score ≤1.0, and neither worse than baseline, a. CDAI-defined clinical remission at Week 52. b. Endoscopic response at Week 52. c. PRO2-defined clinical remission at Week 52.

Source: https://euclinicaltrials.eu/ctis-public/view/2023-509391-42-00